EU clinical trial 2023-508192-36-00: Immunogenicity and safety of a meningococcal serogroup B vaccine in adult patients with asplenia
Protocol code: MenB_Asplenia
Sponsor: Medical University of Vienna (Educational Institution). Phase: Therapeutic exploratory (Phase II). Countries: Austria (ongoing, recruitment ended).
Therapeutic area(s): Diseases [C] - Bacterial Infections and Mycoses [C01]
Gender: Female, Male. Age: 18-64 years. Enrolment: 80.
Status: Ongoing, recruitment ended. Start date (EU): 2024-03-05. Decision date: 2024-02-05. Results received: No. Last updated: 2025-01-02.
Decision dates by country: AT: 2024-02-15

Condition(s): Splenectomy
Product: Bexsero suspension for injection in pre-filled syringe Meningococcal group B Vaccine (rDNA, component, adsorbed)

Primary endpoint: The primary end point is the mean log-titre over the three meningococcal strains (NZ98/254 for PorA, 5/99 for NadA and 44/76-SL for fHbp) as measured by the hSBA one month after second vaccination. The non-inferiority margin was set to a 2-fold titre difference between the geometric mean titre of the asplenic group and the healthy control group.
Endpoint(s): The persistence of antibodies will be measured six months after second vaccination and the difference between the means of the log-titers between the asplenic and the control group will be calculated., The cellular immune response as measured by lymphocyte proliferation assay and cytokine levels., Adverse events (AEs) during the observation period will be tabulated by single events with the number of the vaccination, the type of the event, its severity and evaluation concerning its relation to the vaccination, potential treatment and sequelae.

Source: https://euclinicaltrials.eu/ctis-public/view/2023-508192-36-00